EU clinical trial 2023-509193-32-01: Effect of botulinum toxin on hamstring contracture and the occurrence of cyclops syndrome following anterior cruciate ligament reconstruction
Protocol code: 2020-06-012
Sponsor: Ramsay Generale De Sante, Groupement de Coopération Sanitaire Ramsay Santé pour l’Enseignement et la Recherche (Hospital/Clinic/Other health care facility, Educational Institution). Phase: Therapeutic exploratory (Phase II). Countries: France (ended).
Therapeutic area(s): Analytical,Diagnostic,Therapeutic Techniques and Equipment [E]-Surgical Procedures, Operative [E04]
Gender: Female, Male. Age: 18-64 years. Enrolment: 132.
Status: Ended. Start date (EU): 2024-07-18. End date (EU): 2025-07-10. Decision date: 2024-05-16. Results received: No. Last updated: 2025-04-11.

Condition(s): Cyclops syndrome

Source: https://euclinicaltrials.eu/ctis-public/view/2023-509193-32-01